EU clinical trial 2023-504405-37-00: Assessment of the influence of the gut microbiome on tacrolimus pharmacokinetics in healthy volunteers
Protocol code: K806
Sponsor: Universitaetsklinikum Heidelberg AöR (Hospital/Clinic/Other health care facility). Phase: Human Pharmacology (Phase I)- Other. Countries: Germany (ended).
Therapeutic area(s): Phenomena and Processes [G] - Metabolism [G03]; Phenomena and Processes [G] - Biological Phenomena [G16]; Phenomena and Processes [G] - Digestive System and Oral Physiological Phenomena [G10]; Phenomena and Processes [G] - Microbiological Phenomena [G06]
Gender: Female, Male. Age: 18-64 years. Enrolment: 20.
Status: Ended. Start date (EU): 2023-08-02. End date (EU): 2024-03-28. Decision date: 2023-07-31. Results received: No. Last updated: 2023-07-31.

Condition(s): Pharmacokinetic trial in healthy volunteers

Source: https://euclinicaltrials.eu/ctis-public/view/2023-504405-37-00